EU clinical trial 2022-502953-32-01: A Phase 1b/2 Single and Multiple Dose Study to Assess the Safety, Tolerability, Clinical Activity, Pharmacokinetics, Pharmacodynamics, and Immunogenicity of STAR-0215 in Participants with Hereditary Angioedema (The ALPHA-STAR Trial)
Protocol code: STAR-0215-201
Sponsor: Astria Therapeutics Inc. (Pharmaceutical company). Phase: Phase I and Phase II (Integrated)- Other. Countries: Czechia (ended), Poland (ended), Bulgaria (ended), Germany (ended).
Therapeutic area(s): Diseases [C] - Congenital, Hereditary, and Neonatal Diseases and Abnormalities [C16]
Gender: Female, Male. Age: 18-64 years, 65+ years. Enrolment: 25.
Status: Ended. Start date (EU): 2024-04-02. End date (EU): 2025-03-13. End date: 2025-03-14. Decision date: 2023-10-05. Results received: Yes. Last updated: 2025-03-18.
Decision dates by country: PL: 2023-10-09, DE: 2023-10-06, BG: 2023-10-09, CZ: 2023-10-05

Condition(s): Hereditary Angioedema (HAE)
Product: STAR-0215

Primary endpoint: Incidence of adverse events, Changes in vital signs, ECG findings, physical examination findings, and clinical laboratory evaluations
Endpoint(s): Change from baseline in monthly HAE attack rate, Incidence of HAE attack severity (mild, moderate, and severe), Duration of HAE attack (shorter than 12 hours,12 to 24 hours, 24 to 48 hours, and longer than 48 hours), The number of HAE attacks requiring on-demand therapy, Time to first HAE attack after first and last dosing, Concentration of STAR-0215 and the derived PK parameters, Change in plasma kallikrein activity, Formation of anti-drug (STAR-0215) antibodies

Source: https://euclinicaltrials.eu/ctis-public/view/2022-502953-32-01